EU clinical trial 2024-519109-36-00: Bioequivalence of Canagliflozin 300 mg Film-Coated Tablets in Healthy Participants Under Fasting Conditions.
Protocol code: BLCL-CAN-EU-01
Sponsor: Tecnimede-Sociedade Tecnico-Medicinal S.A. (Pharmaceutical company). Phase: Human Pharmacology (Phase I)- Bioequivalence Study. Countries: Portugal (ended).
Therapeutic area(s): Not possible to specify
Gender: Female, Male. Age: 18-64 years. Enrolment: 58.
Status: Ended. Start date (EU): 2025-07-09. End date (EU): 2025-08-15. Decision date: 2025-06-24. Results received: No. Last updated: 2025-06-24.

Condition(s): No medical condition.

Source: https://euclinicaltrials.eu/ctis-public/view/2024-519109-36-00